EU clinical trial 2023-503864-17-00: A study to learn how much elinzanetant gets into the blood, how safe it is and how it affects the body after taking single and multiple amounts in healthy subjects
Protocol code: 22382
Sponsor: Bayer Consumer Care AG, Bayer Consumer Care AG, Bayer AG (Pharmaceutical company). Phase: Human Pharmacology (Phase I)- Other. Countries: Germany (ended).
Therapeutic area(s): Diseases [C] - Hormonal diseases [C19]
Gender: Female, Male. Age: 18-64 years. Enrolment: 36.
Status: Ended. Start date (EU): 2023-09-20. End date (EU): 2024-02-23. Decision date: 2023-08-08. Results received: No. Last updated: 2023-10-06.

Condition(s): Vasomotor Symptoms as a sex hormone-dependent disorder in women and men

Source: https://euclinicaltrials.eu/ctis-public/view/2023-503864-17-00